EU clinical trial 2023-508558-25-01: Tolerogenic dendritic cell therapy in type 1 diabetes; a phase 1b safety and immunological effecitivity study
Sponsor: Academisch Ziekenhuis Leiden (Hospital/Clinic/Other health care facility). Phase: Phase I and Phase II (Integrated)- Other. Countries: Netherlands (ongoing, recruiting).
Therapeutic area(s): Diseases [C] - Immune System Diseases [C20]
Gender: Female, Male. Age: 18-64 years. Enrolment: 10.
Status: Ongoing, recruiting. Start date (EU): 2024-12-02. Decision date: 2024-10-30. Results received: No. Last updated: 2026-03-24.

Condition(s): Type 1 Diabetes

Source: https://euclinicaltrials.eu/ctis-public/view/2023-508558-25-01